EU clinical trial 2024-516628-32-00: STOP-I-SEP_Disease modifying therapies withdrawal in inactive Secondary Progressive Multiple Sclerosis patients older than 50 years
Protocol code: 35RC17_8842_STOPISEP
Sponsor: Centre Hospitalier Universitaire De Rennes (Hospital/Clinic/Other health care facility). Phase: Therapeutic confirmatory (Phase III). Countries: France (ongoing, recruitment ended).
Therapeutic area(s): Diseases [C] - Nervous System Diseases [C10]
Gender: Female, Male. Age: 18-64 years, 65+ years. Enrolment: 250.
Status: Ongoing, recruitment ended. Start date (EU): 2019-01-24. Decision date: 2024-10-10. Results received: No. Last updated: 2026-04-10.

Condition(s): Multiple Sclerosis
Product: INTERFERON BETA-1B, AZATHIOPRINE, TERIFLUNOMIDE, GLATIRAMER ACETATE, CYCLOPHOSPHAMIDE, GLATIRAMER ACETATE, DIMETHYL FUMARATE, METHOTREXATE, METHOTREXATE, MYCOPHENOLATE MOFETIL, OCRELIZUMAB, CYCLOPHOSPHAMIDE, INTERFERON BETA-1A, CYCLOPHOSPHAMIDE, MYCOPHENOLATE MOFETIL, INTERFERON BETA-1A, PEGINTERFERON BETA-1A, INTERFERON BETA-1A, RITUXIMAB

Primary endpoint: Percentage of patients experiencing disability progression (confirmed at 6 months) at 2 years. Disability progression will be defined as an increase in the EDSS of at least 1 point if the baseline EDSS was 5.5 or less, or 0.5 point if the Baseline EDSS was more than 5.5.
Endpoint(s): Disability - Time from DMT withdrawal to disability progression confirmed at 6 months; - Change in a composite disability progression score (increase in the EDSS score, or an increase in the time to perform the timed 25-foot walk ≥ 20%, or an increase in the time to complete the 9-hole peg test ≥ 20%) confirmed at 6 months; - Change in the SDMT score from baseline to 2-year;, Relapses - Percentage of patients with at least one relapse from baseline to 2-year; - Annualized relapse rate during 2-year; - Time from DMT withdrawal to first relapse;, MRI - Percentage of patients with one or more new or enlarging brain MRI lesions from baseline to 2-year; - Percentage of patients with at least one gadolinium enhancing lesion(s) at 6 months, and/or 1 year,and/or 2-year; - Change in brain volume from baseline to 2-year;, Disease free survival - Percentage of patients with no evidence of disease activity (NEDA 3: no clinical relapse, no MRI activity, no disability progression) at 2-year; - Percentage of patients who resume DMT in the treatment withdrawal group at 2-year, Quality of life - Change in the SEP-59 score from baseline to 2-year; - Change in the EuroQOL EQ-5D from baseline to 2-year;, Medico economic impact - Incremental Cost Effectiveness Ratio (ICER) defined as the cost for QALY gained in “treatment withdrawal group” versus “treatment continued group”.

Source: https://euclinicaltrials.eu/ctis-public/view/2024-516628-32-00